EU clinical trial 2025-524722-17-00: Short and long-term Hemodynamic and Physiological Effects of Mavacamten in Obstructive Hypertrophic Cardiomyopathy
Sponsor: Region Skane (Hospital/Clinic/Other health care facility). Phase: Therapeutic use (Phase IV). Countries: Sweden (authorised, recruitment pending).
Therapeutic area(s): Diseases [C] - Cardiovascular Diseases [C14]
Gender: Female, Male. Age: 18-64 years, 65+ years. Enrolment: 40.
Status: Authorised, recruitment pending. Decision date: 2026-06-26. Results received: No. Last updated: 2026-06-26.

Condition(s): Obstructive Hypertrophic Cardiomyopathy
Product: CAMZYOS 10 mg hard capsules

Primary endpoint: Change in myocardial perfusion reserve (MPR) (averaged values across all hypertrophied myocardial segments without significant LGE) from baseline to 2 years after initiation of treatment.
Endpoint(s): Change in MPR from BL to 12 weeks, Change in MPR from BL to 1 year, Changes in T1, T2 and extracellular volume (ECV) mapping from BL to 12 w, 1 year and 2 years, Change in LGE extent from BL to 12 w, 1 year and 2 years, Change in stroke work, ventricular efficiency, contractility, and arterial elastance assessed by P-V-loop-analysis from BL to 12 w, 1 year and 2 years, Change in kinetic energy and regional pressure gradients assessed by 4D flow-analysis from BL to 12 w, 1 year and 2 years, Changes in myocardial mass and left atrial volume assessed by standard CMR from BL to 12 w, 1 year and 2 years

Source: https://euclinicaltrials.eu/ctis-public/view/2025-524722-17-00